EU clinical trial 2024-512863-30-00: Deciphering B and T cell Co-stimulation for the Targeted Treatment of IgG4-Related Disease
Sponsor: Ospedale San Raffaele S.r.l. (Hospital/Clinic/Other health care facility). Phase: Therapeutic exploratory (Phase II). Countries: Italy (ongoing, recruiting).
Therapeutic area(s): Diseases [C] - Immune System Diseases [C20]
Gender: Female, Male. Age: 18-64 years, 65+ years. Enrolment: 32.
Status: Ongoing, recruiting. Start date (EU): 2024-12-09. Decision date: 2024-04-16. Results received: No. Last updated: 2024-04-16.

Condition(s): IgG4-related disease
Product: ABATACEPT

Primary endpoint: Reduction of disease recurrence in patients with IgG4-related disease treated with abatacept compared with placebo-treated pazineti

Source: https://euclinicaltrials.eu/ctis-public/view/2024-512863-30-00